EU clinical trial 2023-503376-24-00: A Randomized, Open-label, Phase 3 Study of MK-2870 in Combination With Pembrolizumab Compared to Pembrolizumab Monotherapy in the First-line Treatment of Participants With Metastatic Non-small Cell Lung Cancer With PD-L1 TPS Greater than or Equal to 50% (TroFuse-007)
Protocol code: MK-2870-007
Sponsor: Merck Sharp & Dohme LLC (Pharmaceutical company). Phase: Therapeutic confirmatory (Phase III). Countries: Portugal (ongoing, recruiting), France (ongoing, recruiting), Italy (ongoing, recruiting), Germany (ongoing, recruiting), Spain (ongoing, recruiting), Netherlands (ongoing, recruiting), Czechia (ongoing, recruiting), Denmark (ongoing, recruiting), Poland (ongoing, recruiting).
Therapeutic area(s): Diseases [C] - Neoplasms [C04]
Gender: Female, Male. Age: 18-64 years, 65+ years. Enrolment: 196.
Status: Ongoing, recruiting. Start date (EU): 2024-03-20. Decision date: 2024-03-12. Results received: No. Last updated: 2026-07-06.
Decision dates by country: IT: 2024-03-13, ES: 2024-03-14, DE: 2024-03-18, DK: 2024-03-12, CZ: 2024-03-13, FR: 2024-03-14, NL: 2024-03-18, PL: 2024-03-15, PT: 2024-03-14

Condition(s): Metastatic non-small cell lung cancer (NSCLC)
Product: PARACETAMOL, COMBINATIONS EXCL. PSYCHOLEPTICS, KEYTRUDA 25 mg/mL concentrate for solution for infusion, MK-2870, MK-2870, DEXAMETHASONE

Primary endpoint: Overall Survival (OS)
Endpoint(s): Progression free survival (PFS), Objective Response (OR), Duration of Response (DOR), Change from Baseline in Global Health Status/Quality of Life (QOL) Score [European Organisation for Research and Treatment of Cancer (EORTC) Core Quality of Life Questionnaire (QLQ-C30) Items 29 and 30], Change From Baseline in Dyspnea Score (EORTC QLQ-C30 Item 8), Change From Baseline in Cough Score (EORTC QLQ-LC13 Item 31), Change From Baseline in Chest Pain Score (EORTC QLQ-LC13 Item 40), Time to Deterioration (TTD) Based on Change from Baseline in Global Health Status (GHS)/ QOL Score (EORTC QLQ-C30 Items 29 and 30), TTD Based on Change from Baseline in Dyspnea Score (EORTC QLQ-C30 Item 8), TTD Based on Change from Baseline in Cough Score (EORTC QLQ-LC13 Item 31), TTD Based on Change from Baseline in Chest Pain Score (EORTC QLQ-LC13 Item 40), Percentage of Participants that Experience at Least One Adverse Event (AE), Percentage of Participants who Discontinue Study Treatment Due to an AE

Source: https://euclinicaltrials.eu/ctis-public/view/2023-503376-24-00